EU clinical trial 2023-506007-26-00: DAREONTM-9: A study to test how well different doses of BI 764532 are tolerated by people with small cell lung cancer when taken together with a single agent chemotherapy
Protocol code: 1438-0009
Sponsor: Boehringer Ingelheim International GmbH (Pharmaceutical company). Phase: Human Pharmacology (Phase I)- Other. Countries: Germany (ongoing, recruitment ended), France (ongoing, recruitment ended), Poland (ongoing, recruitment ended).
Therapeutic area(s): Diseases [C] - Neoplasms [C04]
Gender: Female, Male. Age: 18-64 years, 65+ years. Enrolment: 71.
Status: Ongoing, recruitment ended. Start date (EU): 2024-01-15. Decision date: 2023-12-11. Results received: No. Last updated: 2026-04-09.
Decision dates by country: PL: 2024-03-25, DE: 2023-12-07, FR: 2024-03-07

Condition(s): relapsed/refractory extensive stage - small cell lung cancer (ES-SCLC)

Source: https://euclinicaltrials.eu/ctis-public/view/2023-506007-26-00